EU clinical trial 2022-502899-23-00: A RANDOMIZED, DOUBLE-BLIND, PLACEBO-CONTROLLED, MULTICENTER STUDY TO ASSESS THE EFFICACY AND SAFETY OF RIFAXIMIN SOLUBLE SOLID DISPERSION (SSD) TABLETS FOR THE DELAY OF ENCEPHALOPATHY DECOMPENSATION IN CIRRHOSIS (RED-C)
Protocol code: RNLC3132
Sponsor: Salix Pharmaceuticals Inc. (Pharmaceutical company). Phase: Therapeutic confirmatory (Phase III). Countries: Italy (ended), Germany (ended), France (ended), Poland (ended), Spain (ended), Hungary (ended), Belgium (ended), Bulgaria (ended).
Therapeutic area(s): Diseases [C] - Digestive System Diseases [C06]
Gender: Female, Male. Age: 18-64 years, 65+ years. Enrolment: 222.
Status: Ended. Start date (EU): 2024-04-23. End date (EU): 2025-10-09. End date: 2025-10-27. Decision date: 2023-08-10. Results received: Yes. Last updated: 2025-10-22.
Decision dates by country: BG: 2023-08-15, ES: 2023-08-10, BE: 2023-08-16, IT: 2023-08-10, HU: 2023-08-15, DE: 2023-08-15, PL: 2023-08-17, FR: 2023-08-16

Condition(s): Hepatic Encephalopathy (OHE)
Product: Placebo, Rifaximin 40 mg Soluble Solid Dispersion Immediate Release Tablets (SSD-40IR)

Primary endpoint: Time to first event of OHE requiring hospitalization. • A thorough evaluation of the patient will be carried out to confirm the diagnosis of OHE, which will be made by a trained medical professional (e.g., MD, DO) using American Association for the Study of Liver Disease Guidelines. • Every OHE diagnosis will be evaluated and confirmed to meet endpoint definitions by the Clinical Event Adjudication Committee (CEAC).
Endpoint(s): Time to first Conn score ≥ 2, Time to all-cause hospitalization, Time to first event of OHE that requires hospitalization, or all-cause death

Source: https://euclinicaltrials.eu/ctis-public/view/2022-502899-23-00